EU clinical trial 2023-510228-63-00: Study of Mesenchymal Autologous stem cells as Regenerative Treatment for Multiple Sclerosis (SMART-MS)
Sponsor: Helse Bergen HF (Hospital/Clinic/Other health care facility). Phase: Therapeutic exploratory (Phase II). Countries: Norway (ongoing, recruiting).
Therapeutic area(s): Diseases [C] - Nervous System Diseases [C10]
Gender: Female, Male. Age: 18-64 years. Enrolment: 18.
Status: Ongoing, recruiting. Start date (EU): 2024-05-01. Decision date: 2024-04-30. Results received: No. Last updated: 2024-04-30.

Condition(s): Multiple sclerosis
Product: Sodium Chloride 0.9 % w/v Intravenous Infusion BP, Mesenchymal stem cells

Primary endpoint: Difference in CEP (VEP+SEP+MEP) at 6 months as compared to baseline between MSCs treatment vs. placebo (arm A vs. arm B)
Endpoint(s): Difference in CEP at 12 months (study treatment 1 vs. study treatment 2), Difference in VEP at 6 months (arm A vs. arm B), Difference in VEP at 12 months (study treatment 1 vs. study treatment 2), Difference in SEP at 6 months (arm A vs. arm B), Difference in SEP at 12 months (study treatment 1 vs. study treatment 2), Difference in MEP at 6 months (arm A vs. arm B), Difference in MEP at 12 months (study treatment 1 vs. study treatment 2), Difference in EDSS at 6 months (arm A vs. arm B), Difference in EDSS at 12 months (study treatment 1 vs. study treatment 2), Difference in MRI T2-weighted hyperintense lesion volume at 6 months (arm A vs. arm B), Difference in MRI T2-weighted hyperintense lesion volume at 12 months (study treatment 1 vs. study treatment 2), Difference in MRI T1-weighted hypointense lesion volume at 6 months (arm A vs. arm B), Difference in MRI T1-weighted hypointense lesion volume at 12 months (study treatment 1 vs. study treatment 2), Difference in brain volume at 6 months (arm A vs. arm B), Difference in brain volume at 12 months (study treatment 1 vs. study treatment 2), Difference in visual function (visual acuity, visual field, color vision and contrast sensitivity) at 6 months (arm A vs. arm B), Difference in visual function (visual acuity, visual field, color vision and contrast sensitivity) at 12 months (study treatment 1 vs. study treatment 2), Difference in retinal thickness measured with OCT at 6 months (arm A vs. arm B), Difference in retinal thickness measured with OCT at 12 months (study treatment 1 vs study treatment 2), Difference in Nine-Hole-Peg Test (9-HPT) score at 6 months (arm A vs. arm B), Difference in Nine-Hole-Peg Test (9-HPT) score at 12 months (study treatment 1 vs. study treatment 2), Difference in Timed 25 Foot Walk (T25FW) score at 6 months (arm A vs. arm B), Difference in Timed 25 Foot Walk (T25FW) score at 12 months (study treatment 1 vs. study treatment 2), Difference in the Brief International Cognitive Assessment for Multiple Sclerosis (BICAMS), European Quality of Life 5 dimensions (EQ-5D-5L), Multiple Sclerosis Impact Scale (MSIS) and Fatigue severity scale (FSS) score at 6 months (arm A vs. arm B), Difference in the Brief International Cognitive Assessment for Multiple Sclerosis (BICAMS), European Quality of Life 5 dimensions (EQ-5D-5L), Multiple Sclerosis Impact Scale (MSIS) and Fatigue severity scale (FSS) score at 12 months (study treatment 1 vs. study treatment 2), Difference in serum neurofilament light chain and GFAP at 6 months (arm A vs. arm B), Difference in serum neurofilament light chain and GFAP at 12 monhts (study treatment 1 vs. study treatment 2), Intraindividual CEP (longitudinal) between study treatment 1 vs. study treatment 2 in each patient, Rate and nature of adverse- and serious adverse events during 18 months of follow up, Clinical relevant changes in vital signs during 18 months of follow up, Clinical relevant changes on physical examinations during 18 months of follow up, Clinical relevant changes in clinical laboratory results during 18 months of follow up

Source: https://euclinicaltrials.eu/ctis-public/view/2023-510228-63-00